EU clinical trial 2026-525897-20-00: A study to check whether adding RUTI® to standard BCG treatment for high-risk early-stage bladder cancer is safe and how it changes the body’s defenses, with participants randomly receiving RUTI® or a look-alike treatment.
Protocol code: RJ-RTV-01
Sponsor: Laboratorio Reig Jofre S.A. (Pharmaceutical company). Phase: Human Pharmacology (Phase I)- First administration to humans. Countries: Spain (authorised, recruiting).
Therapeutic area(s): Diseases [C] - Male Urogenital Diseases [C12]
Gender: Female, Male. Age: 18-64 years, 65+ years. Enrolment: 44.
Status: Authorised, recruiting. Start date (EU): 2026-07-17. Decision date: 2026-06-18. Results received: No. Last updated: 2026-06-18.

Condition(s): High-risk non-muscle invasive bladder cancer (NMIBC)

Source: https://euclinicaltrials.eu/ctis-public/view/2026-525897-20-00